EU clinical trial 2024-512763-32-00: Feasibility of the Application of a new Six-month Treatment for multidrug-resistant tuberculosis (MDR-TB) patients in France (FAST-MDR)
Protocol code: APHP230852
Sponsor: Assistance Publique Hopitaux De Paris (Hospital/Clinic/Other health care facility). Phase: Therapeutic confirmatory (Phase III). Countries: France (authorised, recruitment pending).
Therapeutic area(s): Diseases [C] - Bacterial Infections and Mycoses [C01]; Diseases [C] - Respiratory Tract Diseases [C08]
Gender: Female, Male. Age: 18-64 years, 65+ years. Enrolment: 50.
Status: Authorised, recruitment pending. Decision date: 2025-07-31. Results received: No. Last updated: 2025-07-31.

Condition(s): Patients diagnosed at the study sites with rifampicinresistant tuberculosis during the recruitment period will be evaluated for study inclusion.
Product: MOXIFLOXACIN, CLOFAZIMINE, PRETOMANID, LINEZOLID, BEDAQUILINE

Primary endpoint: For BPaLM interventional arm: proportion of study participants achieving sustained treatment success at 18 months after study treatment start, according to 2021 WHO definitions, in the absence of permanent addition of any TB drug to the regimen or >4 consecutive weeks treatment interruption or >4 weeks treatment prolongation. For the historical cohort: proportion of patients achieving treatment success (2021 WHO definitions).

Source: https://euclinicaltrials.eu/ctis-public/view/2024-512763-32-00